EU clinical trial 2023-505287-11-01: Safety, tolerability, and biodistribution of [89Zr]Zr-DFO-APAC (Phase 0) in subjects with peripheral arterial occlusive disease / critical limb ischemia (PAOD/CLI) and healthy volunteers – an open label PET study (CHASE-study)
Sponsor: Aplagon Oy (Pharmaceutical company). Phase: Human Pharmacology (Phase I)- Other. Countries: Netherlands (ongoing, recruiting).
Therapeutic area(s): Diseases [C] - Cardiovascular Diseases [C14]
Gender: Female, Male. Age: 18-64 years, 65+ years. Enrolment: 10.
Status: Ongoing, recruiting. Start date (EU): 2024-02-01. Decision date: 2023-09-07. Results received: No. Last updated: 2026-02-27.

Condition(s): Critical limb ischemia, Peripheral arterial occlusive disease

Source: https://euclinicaltrials.eu/ctis-public/view/2023-505287-11-01